EU clinical trial 2022-501987-16-00: A Randomized, Double Blind, Phase 3 Study of Platinum-Based Chemotherapy With or Without INCMGA00012 in First-Line Metastatic Squamous and Nonsquamous Non–Small Cell Lung Cancer (POD1UM-304)
Protocol code: INCMGA 0012-304
Sponsor: Incyte Corp. (Pharmaceutical company). Phase: Therapeutic confirmatory (Phase III). Countries: Czechia (ended), Bulgaria (ended).
Therapeutic area(s): Diseases [C] - Neoplasms [C04]
Gender: Female, Male. Age: 18-64 years, 65+ years. Enrolment: 14.
Status: Ended. Start date (EU): 2020-10-02. End date (EU): 2026-03-26. Decision date: 2024-06-11. Results received: No. Last updated: 2026-04-07.
Decision dates by country: BG: 2024-06-21, CZ: 2024-06-11

Condition(s): Metastatic nonsquamous or squamous non-small cell lung cancer
Product: Paclitaxel AqVida 6 mg/ml Konzentrat zur Herstellung einer Infusionslösung, Abraxane 5 mg/ml powder for dispersion for infusion., Pemetrexed Accord 500 mg powder for concentrate for solution for infusion., Cisplatinum Accord, 1 mg/ml, koncentrat do sporządzania roztworu do infuzji., Cisplatino Accord Healthcare Italia 1 mg/ml concentrato per soluzione per infusione, Albotiva 25 mg/ml Konzentrat zur Herstellung einer Infusionslösung, Bendatax 6 mg/ ml, Carboplatin Bendalis 10 mg/ml Konzentrat zur Herstellung einer Infusionslösung, Cisplatin NeoCorp 1 mg/ml - Konzentrat zur Herstellung einer Infusionslösung, Pemetrexed Accord 25 mg/ml concentrate for solution for infusion, Carboplatin Accord 10 mg/ml koncentratas infuziniam tirpalui, Pemetrexed Accord 100 mg powder for concentrate for solution for infusion., Retifanlimab (INCMGA00012), Pemetrexed Accord 25 mg/ml concentrate for solution for infusion, Placebo liquid (not containing the active substance, otherwise identical to INCMGA0012), Pemetrexed Sandoz 500 mg Powder for concentrate for solution for infusion

Primary endpoint: OS, defined as the time from randomization until death due to any cause..
Endpoint(s): PFS, defined as the time from randomization until disease progression by RECIST v1.1 as determined by BICR or death due to any cause., ORR, defined as the proportion of participants who have a confirmed CR or PR per RECIST v1.1 based on BICR., DOR, defined as the time from the earliest date of documented response until earliest date of disease progression or death from any cause, whichever comes first, per RECIST v1.1 based on BICR., Number of participants experiencing AEs and number of participants discontinuing study drug due to AEs., Population PK parameters (including Cmax, AUC) will be summarized.

Source: https://euclinicaltrials.eu/ctis-public/view/2022-501987-16-00